EU clinical trial 2023-508679-34-00: A Phase 2, Randomized, Double-Blind, Placebo-Controlled Study to Evaluate the Efficacy and Safety of Rosnilimab in Subjects with Moderate to Severe Ulcerative Colitis
Protocol code: ANB030-204
Sponsor: Anaptysbio Inc. (Pharmaceutical company). Phase: Therapeutic exploratory (Phase II). Countries: France (ended), Germany (ended), Austria (ended), Spain (ended), Netherlands (ended), Croatia (ended), Romania (ended), Bulgaria (ended), Italy (ended), Poland (ended).
Therapeutic area(s): Diseases [C] - Digestive System Diseases [C06]
Gender: Female, Male. Age: 18-64 years, 65+ years. Enrolment: 93.
Status: Ended. Start date (EU): 2024-07-30. End date (EU): 2025-11-26. End date: 2026-01-08. Decision date: 2024-03-28. Results received: No. Last updated: 2025-10-02.
Decision dates by country: HR: 2024-03-29, ES: 2024-04-01, RO: 2024-04-01, NL: 2024-04-10, AT: 2024-04-02, FR: 2024-03-29, DE: 2024-04-02, BG: 2024-04-01, PL: 2024-04-02, IT: 2024-03-28

Condition(s): Ulcerative Colitis
Product: Rosnilimab, Placebo to match Rosnilimab solution for injection

Primary endpoint: Primary Efficacy Endpoint • Mean change from Baseline in mMS at Week 12
Endpoint(s): 1. Secondary Efficacy Endpoints • Proportion of subjects achieving clinical remission (defined as a mMS ≤ 2, with a stool frequency subscore (SFS) ≤ 1, RBS = 0, and endoscopic subscore ≤ 1 without friability) at Week 12, 2. Secondary Efficacy Endpoints •Proportion of subjects showing endoscopic improvement (defined as an endoscopy subscore ≤ 1 without friability) at Week 12, 3. Secondary Efficacy Endpoints •Proportion of subjects achieving a clinical response (defined as a decrease from Baseline in mMS ≥ 2 points and ≥ 30% with a decrease from Baseline in RBS ≥ 1 point or an absolute RBS ≤ 1) at Week 12, 4. Exploratory Efficacy Endpoints • Proportion of subjects achieving endoscopic remission (defined as an endoscopy subscore = 0) at Weeks 12, 24 and 50, 5. Exploratory Efficacy Endpoints • Proportion of subjects achieving histologic-endoscopic mucosal improvement (defined as an endoscopic subscore of 0 and a Geboes score ≤2) at Weeks 12, 24 and 50, 8. Exploratory Efficacy Endpoints • Mean change from Baseline in the following assessments at each time point indicated in the SoAs (Table 1 and Table 2): o mMS o pmMS o IBDQ o Individual mMS subscores (RBS, SFS, and endoscopy subscore) o Geboes score, 9. Safety Endpoints • Incidence, type, and severity of AEs, SAEs, and AEs leading to treatment discontinuation and study withdrawal, 10. Safety Endpoints • Change from Baseline in vital signs and clinical laboratory parameters, 11. Exploratory PK Endpoints • Mean observed predose (trough) rosnilimab concentration (Ctrough) at each time point indicated in the SoAs (Table 1 and Table 2), 12. Exploratory PD Endpoints • Mean change from Baseline in exploratory biomarkers at each time point indicated in the SoAs (Table 1 and Table 2), 13. Exploratory Immunogenicity Endpoints • Number and percentage of subjects at each time point indicated in the SoAs (Table 1 and Table 2) with confirmed positive ADA status and corresponding titer, 6. Exploratory Efficacy Endpoints • Proportion of subjects achieving clinical remission (defined as a mMS ≤ 2, with a stool frequency subscore (SFS) ≤ 1, RBS = 0, and endoscopic subscore ≤ 1 without friability) at Weeks 24 and 50, 7. Exploratory Efficacy Endpoints • Proportion of subjects showing endoscopic improvement (defined as an endoscopy subscore ≤ 1 without friability) at Weeks 24 and 50

Source: https://euclinicaltrials.eu/ctis-public/view/2023-508679-34-00